EU clinical trial 2024-513939-24-00: Cultured Autologous Oral Mucosa Epithelial sheet for the Treatment of Bilateral Limbal Stem Cell Deficiency FEMJA for « Feuillet Epithélial de Muqueuse Jugale Autologue »
Protocol code: 69HCL19_0032
Sponsor: Hospices Civils De Lyon (Hospital/Clinic/Other health care facility). Phase: Phase I and Phase II (Integrated)- First administration to humans. Countries: France (ongoing, recruiting).
Therapeutic area(s): Diseases [C] - Eye Diseases [C11]
Gender: Female, Male. Age: 18-64 years, 65+ years. Enrolment: 40.
Status: Ongoing, recruiting. Start date (EU): 2020-11-13. Decision date: 2024-09-19. Results received: No. Last updated: 2026-06-08.

Condition(s): Bilateral Limbal Stem Cell Deficiency

Source: https://euclinicaltrials.eu/ctis-public/view/2024-513939-24-00